EU clinical trial 2024-511457-22-00: A Study to Investigate the Safety and Efficacy of KQB198 as Monotherapy and in Combination in Participants with Advanced Hematologic Malignancies
Protocol code: KQB198-102
Sponsor: Kumquat Biosciences Inc. (Laboratory/Research/Testing facility). Phase: Human Pharmacology (Phase I)- Other. Countries: France (ended), Germany (ended), Spain (ongoing, recruitment ended), Poland (ongoing, recruitment ended), Italy (ongoing, recruitment ended), Netherlands (ended).
Therapeutic area(s): Diseases [C] - Neoplasms [C04]
Gender: Female, Male. Age: 18-64 years, 65+ years. Enrolment: 69.
Start date (EU): 2025-01-30. Decision date: 2025-01-15. Results received: No. Last updated: 2026-07-13.
Decision dates by country: NL: 2025-04-29, DE: 2025-01-17, FR: 2025-01-15, PL: 2025-01-21, ES: 2025-01-15, IT: 2025-01-16

Condition(s): Advanced Hematologic Malignancies

Source: https://euclinicaltrials.eu/ctis-public/view/2024-511457-22-00